EU clinical trial 2022-501971-24-00: A Phase 3 Double-blinded, Two-arm Study to Evaluate the Safety and Efficacy of Pembrolizumab (MK-3475) versus Placebo as Adjuvant Therapy in Participants with Hepatocellular Carcinoma and Complete Radiological Response after Surgical Resection or Local Ablation (KEYNOTE-937)
Protocol code: MK-3475-937
Sponsor: Merck Sharp & Dohme LLC (Pharmaceutical company). Phase: Therapeutic confirmatory (Phase III). Countries: Germany (ended), Belgium (ended), Italy (ended), France (ended), Sweden (ended), Hungary (ended), Spain (ended), Denmark (ended), Norway (ended), Ireland (ended), Poland (ended).
Therapeutic area(s): Diseases [C] - Neoplasms [C04]
Gender: Female, Male. Age: 18-64 years, 65+ years. Enrolment: 260.
Status: Ended. Start date (EU): 2019-05-20. End date (EU): 2025-07-29. End date: 2025-09-30. Decision date: 2023-06-19. Results received: No. Last updated: 2025-09-05.
Decision dates by country: FR: 2023-07-10, DE: 2023-07-19, PL: 2023-07-31, ES: 2023-06-21, SE: 2023-06-19, HU: 2023-06-20, DK: 2023-07-03, BE: 2023-07-20, NO: 2023-06-21, IT: 2023-07-27, IE: 2023-07-07

Condition(s): Adjuvant treatment of HCC
Product: KEYTRUDA 25 mg/mL concentrate for solution for infusion, Placebo to Keytruda - Normal saline

Primary endpoint: Recurrence-Free Survival (RFS), Overall Survival (OS)
Endpoint(s): Percentage of participants who experience an adverse event (AE), Percentage of participants who discontinue study treatment due to an AE, Change from Baseline in European Organization for Research and Treatment of Cancer (EORTC) Quality of Life Questionnaire-Core 30 (QLQ-C30) Overall Scores and Subscale Scores, Change from Baseline in EORTC QLQ-Hepatocellular Carcinoma Module (EORTC QLQ-HCC18) Scale Score, Change from Baseline in European Quality of Life (EuroQoL)-5 Dimensions, 5-level Questionnaire (EQ-5D-5L) Health Utility Score

Source: https://euclinicaltrials.eu/ctis-public/view/2022-501971-24-00